EU clinical trial 2024-513933-18-00: (The Lion Trial) LAIV induced Immune respOnse in the Nasopharynx
Sponsor: Leids Universitair Medisch Centrum (LUMC) (Hospital/Clinic/Other health care facility). Phase: Therapeutic use (Phase IV). Countries: Netherlands (ended).
Therapeutic area(s): Diseases [C] - Respiratory Tract Diseases [C08]
Gender: Female, Male. Age: 0-17 years. Enrolment: 20.
Status: Ended. Start date (EU): 2025-09-18. End date (EU): 2026-06-09. Decision date: 2025-07-24. Results received: No. Last updated: 2025-07-24.

Condition(s): Influenza
Product: Fluenz nasal spray suspension Influenza vaccine (live attenuated, nasal)

Primary endpoint: Presence or absence of viral shedding of vaccine-strains after first and second dose of LAIV in nasal lining fluid, collected using nasosorptions and analyzed with RT-qPCR.
Endpoint(s): LAIV shedding kinetics (density and duration) during first and second dose of LAIV, measured in nasal lining fluid using nasosorptions and analyzed with RT-qPCR., Change in influenza specific mucosal antibodies (including IgA) in nasal lining fluid before and after first and second dose of LAIV. Measured in nasal lining fluid from nasosorptions and analyzed for binding and/or functional capacity., Nasal immune responses during LAIV, with soluble proteins measured in nasal lining fluid from nasosorption samples., Nasal colonization and infection dynamics by other URT bacteria and viruses, comparing composition before and after LAIV. Samples will be collected using nasosorptions and analyzed with molecular methods., Analysis of peripheral immune system in whole blood collected at baseline and 28 days post LAIV dose 1. Measured using tools such as spectral flow cytometry., Serum and mucosal IgG and IgA post-LAIV, comparing baseline to day 28 post-LAIV. Measured through binding and functional assays., Correlating immune responses and shedding kinetics with data from baseline questionnaire and daily questionnaires assessing RTI-related symptoms. Collected using electronic recordings.

Source: https://euclinicaltrials.eu/ctis-public/view/2024-513933-18-00